EU clinical trial 2024-514927-40-02: TORCH: Tranexamic Acid to Prevent Operation in Chronic Subdural Hematoma
Sponsor: Stichting Amsterdam UMC (Hospital/Clinic/Other health care facility). Phase: Phase III and phase IV (Integrated). Countries: Netherlands (ongoing, recruiting).
Therapeutic area(s): Diseases [C] - Nervous System Diseases [C10]
Gender: Female, Male. Age: 18-64 years, 65+ years. Enrolment: 554.
Status: Ongoing, recruiting. Start date (EU): 2024-10-01. Decision date: 2024-09-23. Results received: No. Last updated: 2025-03-18.

Condition(s): Chronic Subdural Hematoma
Product: The placebo capsules are not over-encapsulated, and only contain a mixture of cellulose and magnesium., TRANEXAMIC ACID

Primary endpoint: Need to undergo surgery for chronic subdural hematoma within 12 weeks after TXA treatment initiation less often compared to those receiving a placebo

Source: https://euclinicaltrials.eu/ctis-public/view/2024-514927-40-02